EU clinical trial 2023-506460-14-00: A Phase III, Randomised, Double-blind, Placebo-controlled, Event-driven Study to Assess the Efficacy, Safety and Tolerability of Baxdrostat in Combination with Dapagliflozin Compared with Dapagliflozin Alone on Renal Outcomes and Cardiovascular Mortality in Participants with Chronic Kidney Disease and High Blood Pressure.
Protocol code: D6972C00002
Sponsor: Astrazeneca AB (Pharmaceutical company). Phase: Therapeutic confirmatory (Phase III). Countries: Sweden (ongoing, recruiting), Czechia (ongoing, recruiting), Germany (ongoing, recruiting), Spain (ongoing, recruiting), Poland (ongoing, recruiting), Belgium (ongoing, recruiting), Italy (ongoing, recruiting), Bulgaria (ongoing, recruiting), Netherlands (ongoing, recruiting), Hungary (ongoing, recruiting), Romania (ongoing, recruiting), Denmark (ongoing, recruiting), Greece (ongoing, recruiting), France (ongoing, recruiting), Slovakia (ongoing, recruiting).
Therapeutic area(s): Diseases [C] - Cardiovascular Diseases [C14]
Gender: Female, Male. Age: 18-64 years, 65+ years. Enrolment: 1134.
Status: Ongoing, recruiting. Start date (EU): 2025-05-07. Decision date: 2025-04-14. Results received: No. Last updated: 2026-07-13.
Decision dates by country: GR: 2025-04-15, HU: 2025-04-17, FR: 2025-04-17, PL: 2025-04-23, BG: 2025-04-15, ES: 2025-04-14, BE: 2025-04-14, NL: 2025-04-22, CZ: 2025-04-15, DE: 2025-04-15, RO: 2025-04-22, IT: 2025-04-23, DK: 2025-04-28, SE: 2025-04-15, SK: 2025-04-14

Condition(s): Chronic kidney disease (CKD) and hypertension.
Product: Baxdrostat, Baxdrostat, Forxiga 10 mg film-coated tablets, Baxdrostat placebo, Baxdrostat

Primary endpoint: 1. Time to the first occurrence of any of the components of the composite of: • Kidney disease progression • ≥ 50% sustained decline in eGFR • Onset of kidney failure: - Sustained eGFR < 15 mL/min/1.73 m2 or - Chronic dialysis treatment or - Receiving a kidney transplant or - Death with a renal primary cause (death due to kidney failure when dialysis is not given) • CV events • HF with or without hopsitalization • CV death
Endpoint(s): 1. Time to the first occurrence of any of the components of the composite of: • ≥ 50% sustained decline in eGFR • Onset of kidney failure: - Sustained eGFR < 15 mL/min/1.73 m2 or - Chronic dialysis treatment or - Receiving a kidney transplant or - Death with a renal primary cause (death due to kidney failure when dialysis is not given) • CV death, 2. Time to the first occurrence of any of the components of the composite of: • CV death • HF with or without hospitalization • MI • stroke, 3. CV death, 4. Time to all-cause death

Source: https://euclinicaltrials.eu/ctis-public/view/2023-506460-14-00